EU clinical trial 2022-502604-67-00: Nivolumab and ipilimumab +/- UV1 vaccination as second line treatment in patients with malignant mesothelioma (the NIPU-study)
Sponsor: Oslo University Hospital Hf (Hospital/Clinic/Other health care facility). Phase: Phase II and Phase III (Integrated). Countries: Denmark (ongoing, recruitment ended), Sweden (ongoing, recruitment ended), Spain (ongoing, recruitment ended), Norway (ongoing, recruitment ended).
Therapeutic area(s): Diseases [C] - Neoplasms [C04]; Diseases [C] - Respiratory Tract Diseases [C08]
Gender: Female, Male. Age: 18-64 years, 65+ years. Enrolment: 90.
Status: Ongoing, recruitment ended. Start date (EU): 2019-12-20. Decision date: 2023-02-17. Results received: No. Last updated: 2025-04-03.
Decision dates by country: ES: 2023-02-20, SE: 2023-02-20, NO: 2023-02-17, DK: 2023-02-20

Condition(s): Malignant pleural mesothelioma (MPM)
Product: YERVOY 5 mg/ml concentrate for solution for infusion, Leukine, OPDIVO 10 mg/mL concentrate for solution for infusion.

Primary endpoint: Progression-free survival (PFS) per Modified Response Evaluation Criteria in Solid Tumours (RECIST) as determined by blinded independent central review (BICR).
Endpoint(s): Overall survival (OS), objective response rate (ORR), disease control rate (DCR), time to response (TTR) and duration of response (DOR)., European Organisation for Research and Treatment of Cancer (EORTC) Quality-of-Life Questionnaire Core 30 (QLQ-C30) and it's Lung Cancer Module (LC13) scores., Adverse events (AEs)., Study drug discontinuations due to AEs.

Source: https://euclinicaltrials.eu/ctis-public/view/2022-502604-67-00